EU clinical trial 2024-511615-16-00: A RANDOMIZED, DOUBLE-BLIND, PLACEBO-CONTROLLED STUDY TO ASSESS THE EFFICACY AND SAFETY OF SCD-044 IN THE TREATMENT OF MODERATE TO SEVERE ATOPIC DERMATITIS
Protocol code: SCD-044-19-16
Sponsor: Sun Pharmaceutical Industries Limited (Pharmaceutical company). Phase: Therapeutic exploratory (Phase II). Countries: Poland (ended), Estonia (ended).
Therapeutic area(s): Diseases [C] - Skin and Connective Tissue Diseases [C17]
Gender: Female, Male. Age: 18-64 years, 65+ years. Enrolment: 43.
Status: Ended. Start date (EU): 2023-08-25. End date (EU): 2024-11-25. End date: 2025-03-14. Decision date: 2024-10-13. Results received: Yes. Last updated: 2024-10-24.
Decision dates by country: EE: 2024-10-14, PL: 2024-10-13

Condition(s): atopic dermatitis
Product: SCD-044 Tablets 0.1mg, SCD-044 Tablets 0.6mg, SCD-044 Tablets 0.3mg, SCD-044 Tablets 1.0mg, placebo to match SCD-044 tablets

Primary endpoint: Proportion of subjects who achieve ≥75% overall improvement in EASI score from Baseline
Endpoint(s): Proportion of subjects who achieve score of '0' or '1' on a 5-point, vIGA scale and ≥2 point reduction from Baseline to Week 16

Source: https://euclinicaltrials.eu/ctis-public/view/2024-511615-16-00